EU clinical trial 2025-522139-33-00: An Open-Label, Phase I/II First-in-Human, Dose Escalation, Dose Optimisation and Dose Expansion Study to Evaluate the Safety, Tolerability, Pharmacokinetic, Pharmacodynamic, Immunogenicity and Antitumour Activity of IPN60300 as Single Agent in Adult Participants with Locally Advanced or Metastatic Solid Tumours.
Protocol code: CLIN-60300-450
Sponsor: Ipsen Pharma (Pharmaceutical company). Phase: Phase I and Phase II (Integrated)- First administration to humans. Countries: France (ongoing, recruiting), Spain (ongoing, recruiting).
Therapeutic area(s): Diseases [C] - Neoplasms [C04]
Gender: Female, Male. Age: 18-64 years, 65+ years. Enrolment: 55.
Status: Ongoing, recruiting. Start date (EU): 2026-02-10. Decision date: 2025-12-23. Results received: No. Last updated: 2026-07-28.
Decision dates by country: ES: 2026-06-05, FR: 2025-12-23

Condition(s): Advanced or metastatic solid tumours
Product: IPN60300

Primary endpoint: Phase Ia: - Percentage of participants with dose limiting toxicity (DLT). Cycle1: within 21 days following study drug administration., Phase Ia and Ib: - Percentage of participants experiencing treatment emergent adverse events (TEAEs) and treatment emergent serious adverse events (TE-SAEs). From the first IPN60300 administration until 30 days after the last dose, Phase Ib: Objective response rate (ORR) - ORR is defined as the percentage of participants with best overall response (BOR) of complete response (CR) or partial response (PR), as determined by investigator per RECIST version 1.1. At end of study (up to approximately 3 years)
Endpoint(s): Phase Ia and Ib: - Percentage of Treatment-Emergent Anti-Drug Antibodies (ADA), Including Binding and Neutralizing Antibodies. Prior study drug administration until the End of Treatment (EoT) visit (approximately up to 3 years), Phase Ia: Time to maximum observed drug concentration (tmax) of IPN60300 after single and multiple doses of IPN60300. At Cycle 1 and Cycle 2: within 21 days following study drug administration, Phase Ia - Maximum observed drug concentration (cmax) of IPN60300 after single and multiple doses of IPN60300. At Cycles 1 and 2: Within 21 days following study drug administration, Phase Ia - Area under the plasma concentration time curve over one dosing interval (AUCtau) of IPN60300 after single and multiple doses of IPN60300. At Cycles 1 and 2: Within 21 days following study drug administration, Phase Ia - Tmax of Total Antibody after single and multiple doses of IPN60300. At Cycles 1 and 2: Within 21 days following study drug administration., Phase Ia - Cmax of Total Antibody after single and multiple doses of IPN60300. At Cycles 1 and 2: Within 21 days following study drug administration., Phase Ia - AUCtau of Total Antibody after single and multiple doses of IPN6030. At Cycles 1 and 2: Within 21 days following study drug administration., Phase Ia - Tmax of free toxin after single and multiple doses of IPN60300. At Cycles 1 and 2: Within 21 days following study drug administration., Phase Ia - Cmax of free toxin after single and multiple doses of IPN60300. At Cycles 1 and 2: Within 21 days following study drug administration., Phase Ia - AUCtau of free toxin after single and multiple doses of IPN60300. At Cycles 1 and 2: Within 21 days following study drug administration., Phase Ia - Objective Response Rate (ORR). ORR is defined as the percentage of participants with BOR of CR or PR, as determined by investigator per RECIST version 1.1. At end of study (up to approximately 3 years), Ph Ib - DoR is defined as the time from the first documented evidence of CR or PR until progressive disease, as determined by investigator per RECIST version 1.1, or death from any cause, whichever occurs first. At end of study (up to approximately 3 years), Ph Ib - PFS is defined as the time from the date of first IPN60300 administration to the date of the first documented disease progression, as determined by investigator per RECIST version 1.1, or death due to any cause, whichever occurs first. At end of study (up to approximately 3 years), Ph Ib - DCR is defined as the percentage of participants with BOR of CR, PR or stable desease (SD), as determined by investigator per RECIST version 1.1. At end of study (up to approximately 3 years)

Source: https://euclinicaltrials.eu/ctis-public/view/2025-522139-33-00